EU clinical trial 2023-505671-74-00: Control Of BioEquivalence with Xenical (COBEX): A Phase I, randomized, active-control study to evaluate EMP22 pharmacodynamics and EMP16 pharmacokinetics versus Xenical® in healthy volunteers.
Protocol code: EP-004
Sponsor: Empros Pharma AB (Pharmaceutical company). Phase: Human Pharmacology (Phase I)- Bioequivalence Study. Countries: Sweden (ended).
Therapeutic area(s): Diseases [C] - Nutritional and Metabolic Diseases [C18]
Gender: Female, Male. Age: 18-64 years. Enrolment: 20.
Status: Ended. Start date (EU): 2023-09-22. End date (EU): 2023-11-22. Decision date: 2023-09-01. Results received: Yes. Last updated: 2023-09-01.

Condition(s): Obesity
Product: Xenical 120 mg hard capsules

Primary endpoint: The percent of faecal fat excretion expressed as a ratio of the amount of fat excretion over a 24-hour period at steady-state relative to the amount of daily ingested fat.
Endpoint(s): Maximum plasma concentration (Cmax), Time to Cmax (Tmax) and area under the plasma concentration vs. time curve from time 0 to time t AUC0-t for orlistat and acarbose, Cmax, Tmax and AUC0-t for orlistat

Source: https://euclinicaltrials.eu/ctis-public/view/2023-505671-74-00